EU clinical trial 2024-519336-16-00: ORACLE - Randomized Phase 3 Study evaluating the Efficacy and the Safety of Oral Azacitidine (CC-486) compared to Investigator’s Choice Therapy in Patient with Relapsed or Refractory Angioimmunoblastic T cell Lymphoma
Sponsor: LYSARC (Laboratory/Research/Testing facility). Phase: Phase II and Phase III (Integrated). Countries: France (ended).
Therapeutic area(s): Diseases [C] - Immune System Diseases [C20]
Gender: Female, Male. Age: 18-64 years, 65+ years. Enrolment: 2.
Status: Ended. Start date (EU): 2018-10-31. End date (EU): 2025-08-28. Decision date: 2024-12-05. Results received: No. Last updated: 2025-06-02.

Condition(s): Relapsed or Refractory Angioimmunoblastic T cell Lymphoma
Product: BENDAMUSTINE HYDROCHLORIDE, AZACITIDINE, GEMCITABINE

Primary endpoint: Progression free survival (PFS)
Endpoint(s): Overall Survival (OS)

Source: https://euclinicaltrials.eu/ctis-public/view/2024-519336-16-00